EU clinical trial 2023-503925-20-00: An Open-label Dosimetry, Biodistribution, Tolerability and Safety Study of lutetium (177Lu) vipivotide tetraxetan in Patients With Progressive PSMA-Positive Metastatic Castration-Resistant Prostate Cancer (mCRPC) with Moderately and Severely Impaired and with normal Renal Function
Protocol code: CAAA617A12202
Sponsor: Novartis Pharma AG (Pharmaceutical company). Phase: Therapeutic exploratory (Phase II). Countries: Italy (ongoing, recruitment ended), Germany (ongoing, recruitment ended), Spain (ongoing, recruitment ended), France (ongoing, recruitment ended).
Therapeutic area(s): Diseases [C] - Neoplasms [C04]
Gender: Male. Age: 18-64 years, 65+ years. Enrolment: 15.
Status: Ongoing, recruitment ended. Start date (EU): 2024-04-04. Decision date: 2023-11-15. Results received: No. Last updated: 2025-11-12.
Decision dates by country: IT: 2023-11-17, ES: 2023-11-16, FR: 2023-11-16, DE: 2023-11-15

Condition(s): Progressive PSMA-Positive Metastatic Castration-Resistant Prostate Cancer (mCRPC) with moderate and severe renal impairment and with normal renal function.
Product: Pluvicto 1 000 MBq/mL solution for injection/infusion, Locametz 25 micrograms kit for radiopharmaceutical preparation

Primary endpoint: Absorbed radiation dose in kidney and selected organs., Concentrations of AAA617 in blood over time and derived pharmacokinetic (PK) parameters from blood radioactivity data., Change from baseline in eGFR using the by-timepoint analysis., Tolerability: dose interruptions, reductions and dose intensity.
Endpoint(s): Change from baseline in QT interval corrected by Fridericia’s formula (QTcF) interval (ΔQTcF) using the by-timepoint analysis., Relationship between drug concentrations and QTcF., Safety: Incidence and severity of adverse events (AEs) and serious adverse events (SAEs), changes in laboratory values, vital signs and electrocardiograms (ECGs). Any clinically significant lab, vital signs, ECG abnormalities will be captured as an AE., ORR and DCR based on PCWG3-modified (The Prostate Cancer Working Group 3) RECIST v1.1 based endpoints using CT/MRI and bone scans by investigator., PSA50 response is defined as the proportion of participants who have a ≥50% decrease in PSA from baseline that is confirmed by a second (the next) PSA measurement ≥4 weeks later, Derived urine PK parameters from urine PK radioactivity data

Source: https://euclinicaltrials.eu/ctis-public/view/2023-503925-20-00